EU clinical trial 2024-512388-29-00: A multicenter, randomized, double-blind, placebo-controlled, parallel, phase 3 study to assess the efficacy and safety of fibrinogen concentrate (FGTW) in the management of bleeding in patients undergoing complex cardiac surgery (involving CPB)
Protocol code: FGTW2101
Sponsor: LFB-Biotechnologies (Pharmaceutical company). Phase: Therapeutic confirmatory (Phase III). Countries: Sweden (ongoing, recruiting), Germany (ongoing, recruiting), Spain (ongoing, recruiting), Italy (ongoing, recruiting), Czechia (ongoing, recruiting).
Therapeutic area(s): Diseases [C] - Cardiovascular Diseases [C14]
Gender: Female, Male. Age: 18-64 years, 65+ years. Enrolment: 104.
Status: Ongoing, recruiting. Start date (EU): 2022-11-29. Decision date: 2024-05-10. Results received: No. Last updated: 2026-03-26.
Decision dates by country: IT: 2024-05-15, DE: 2024-05-15, SE: 2024-05-13, ES: 2024-05-10, CZ: 2025-02-27

Condition(s): Bleeding in patients undergoing complex cardiac surgery involving Cardiopulmonary bypass
Product: FIBRINOGEN, HUMAN, 0.9% Sodium Chloride Solution

Primary endpoint: The primary efficacy endpoint is the number of units of allogeneic blood products (RBC plus FFP plus platelet concentrate) given to patients between IMP administration and 24 hours thereafter.
Endpoint(s): Blood drainage volume during 12 hours after IMP administration or skin closure whichever comes last, Percentage of patients with total avoidance of allogeneic transfusions during 24 hours after IMP administration, Number of transfusion units infused between 24 hours after randomization and the hospital discharge for each class of allogeneic blood product (RBC, FFP, and platelet concentrate), Number of pre-donated autologous RBC concentrate units, RBC concentrate prepared by cell-saver, colloids, and crystalloids after IMP administration until hospital discharge, Mortality at 24 hours, 7 days, and 30 days after IMP administration, Percentage of patients with each surgical morbidity at 24 hours, 7 days, and 30 days after randomization (see Section 9.2.8), Percentage of patients with post-surgery stage 1 AKI (with increase in creatinine by >50% from baseline until hospital discharge), Percentage of patients with surgical re-exploration due to bleeding during 24 hours after IMP administration, Percentage of patients with fibrinogen concentration below the LLN from visit 2 to visit 5, Percentage of patients receiving aPCC/PCCs, rFVIIa, cryoprecipitate or additional FC as rescue therapy within 24 hours after randomization, Duration of hospitalization, Length of stay in ICU

Source: https://euclinicaltrials.eu/ctis-public/view/2024-512388-29-00